EU clinical trial 2022-501493-19-00: A Multi-Center, Open-Label, Randomized Phase 3 Trial Comparing the Safety and Efficacy of [177Lu]LU-PSMA-I&T versus Hormone Therapy in Patients with Metastatic Castration-Resistant Prostate Cancer
Protocol code: CURLu177PSM0001
Sponsor: Curium Pet France (Pharmaceutical company). Phase: Therapeutic confirmatory (Phase III). Countries: Italy (ongoing, recruitment ended), France (ongoing, recruitment ended), Spain (ongoing, recruitment ended).
Therapeutic area(s): Diseases [C] - Male Urogenital Diseases [C12]
Gender: Male. Age: 18-64 years, 65+ years. Enrolment: 150.
Status: Ongoing, recruitment ended. Start date (EU): 2023-02-20. Decision date: 2022-12-06. Results received: No. Last updated: 2026-03-16.
Decision dates by country: ES: 2022-12-13, IT: 2022-12-06, FR: 2022-12-09

Condition(s): metastatic Castration-Resistant Prostate Cancer (mCRPC)
Product: Pylclari 1 000 MBq/mL solution for injection, 177LU-PSMA-I&T, PREDNISONE, ENZALUTAMIDE, ABIRATERONE ACETATE

Primary endpoint: Time from randomization to radiographic progression as determined by Prostate Cancer Working Group 3 (PCWG3) criteria as assessed by blinded independent central review
Endpoint(s): Time from randomization to death by any cause, Time from randomization to the second radiographic progression as determined by PCWG3 or RECIST 1.1 by Blinded Independent Central Review (BICR) after crossover, Time from randomization to progression (PFS, composite) based on the following events, whichever occurs first: PCWG3 or RECIST progression, clinical/symptomatic progression and/or pain progression, or death due to any cause as determined by investigator., Time from randomization to the second progression (PFS, composite) based on the following events, whichever occurs first: PCWG3 or RECIST progression, clinical/symptomatic progression and/or pain progression, or death due to any cause as determined by investigator., PSA50 response rate, defined as a confirmed reduction of PSA from baseline of ≥ 50%, Time from randomization to first symptomatic skeletal event (SSE-free survival), Time from randomization to radiographic soft tissue progression (rSTP) as measured by RECIST 1.1 by BICR., Time from randomization to first use of chemotherapy, Quality of Life improvement based on EORTC QLQ-C30 questionnaire

Source: https://euclinicaltrials.eu/ctis-public/view/2022-501493-19-00